EU clinical trial 2023-508683-30-00: A Registry-Based Extension of Protocol V503-001 in Countries with Centralized Cervical Cancer Screening Infrastructures to Evaluate the Long-Term Effectiveness, immunogenicity, and Safety of Multivalent Human Papillomavirus (HPV) L1 Virus-Like Particle (VLP) Vaccine as Administered to 16- to 26- Year- Old Women.
Protocol code: V503-021
Sponsor: Merck Sharp & Dohme LLC (Pharmaceutical company). Phase: Therapeutic confirmatory (Phase III). Countries: Norway (ongoing, recruiting), Sweden (ended), Denmark (authorised, recruitment pending).
Therapeutic area(s): Diseases [C] - Virus Diseases [C02]
Gender: Female. Age: 18-64 years. Enrolment: 2220.
Start date (EU): 2008-03-14. Decision date: 2024-05-24. Results received: No. Last updated: 2025-12-18.
Decision dates by country: SE: 2024-05-28, DK: 2024-12-01, NO: 2024-05-24

Condition(s): 9vHPV vaccine is indicated in females ≥ 9 years of age in the prevention of cervical, vulvar, vaginal, and anal cancer; precancerous or dysplastic lesions; and persistent infections caused by Human Papillomavirus (HPV) types 16, 18, 31, 33, 45, 52, and 58, and genital warts (condyloma acuminata) caused by HPV types 6 and 11.
Product: Gardasil 9 suspension for injection in a pre-filled syringe. Human Papillomavirus 9-valent Vaccine (Recombinant, adsorbed)

Primary endpoint: Combined Incidence of Human Papillomavirus (HPV) Type 16, 18, 31, 33, 45, 52, or 58-related CIN Grades 2 or 3, Adenocarcinoma in Situ (AIS), and Cervical Cancer in Cohort 1
Endpoint(s): Combined Incidence of CIN 2, CIN 3, AIS, or cervical cancer related to HPV 35, 39, 51, 56, or 59, Combined Incidence of CIN (any grade), AIS, cervical cancer, vulvar cancer, or vaginal cancer related to HPV 6, 11, 16, 18, 31, 33, 45, 52, or 58, Geometric Mean Titers (GMTs) of HPV 6, 11, 16, 18, 31, 33, 45, 52, and 58, Seropositivity rates of HPV 6, 11, 16, 18, 31, 33, 45, 52, and 58

Source: https://euclinicaltrials.eu/ctis-public/view/2023-508683-30-00